EU clinical trial 2025-521178-33-00: A Randomized, Double-Blind, Active-Controlled Multicenter Phase 2 Study Evaluating the Efficacy and Safety of ALG-000184 Compared with Tenofovir Disoproxil Fumarate in Untreated HBeAg-Positive and HBeAg-Negative Adult Subjects with Chronic Hepatitis B Virus Infection (B-SUPREME)
Protocol code: ALG-000184-202
Sponsor: Aligos Therapeutics Inc. (Pharmaceutical company). Phase: Therapeutic exploratory (Phase II). Countries: Spain (ongoing, recruiting), Italy (authorised, recruiting), Bulgaria (ongoing, recruiting), Romania (ongoing, recruiting), France (ongoing, recruiting).
Therapeutic area(s): Diseases [C] - Virus Diseases [C02]
Gender: Female, Male. Age: 18-64 years, 65+ years. Enrolment: 50.
Start date (EU): 2025-12-03. Decision date: 2025-09-24. Results received: No. Last updated: 2026-06-12.
Decision dates by country: BG: 2025-09-29, ES: 2025-09-24, FR: 2025-09-26, RO: 2025-09-29, IT: 2025-09-25

Condition(s): Chronic Hepatitis B Virus Infection
Product: ALG-000184 Placebo, ALG-000184, Tenofovirdisoproxil Amarox 245 mg Filmtabletten, Tenofovir Disoproxil Placebo

Primary endpoint: Part 1 (HBeAg positive): Plasma HBV DNA < LLOQ (10 IU/mL, TD [target detected] or target not detected [TND])at Week 48, Part 2 (HBeAg negative): Plasma HBV DNA < LLOQ (10 IU/mL, TND) at Week 48
Endpoint(s): Safety will be assessed by monitoring treatment-emergent adverse events, physical examinations, vital signs, 12-lead electrocardiograms (ECGs), and clinical laboratory results (including chemistry, blood coagulation, hematology, and urinalysis)., Plasma HBV DNA level at Week 48 categorized according to one of the following ordinal categories: HBV DNA ≥ LLOQ, HBV DNA < LLOQ (TD), and HBV DNA < LLOQ (TND), Plasma HBV DNA < LLOQ (TD or TND) at various time points during the 48-week dosing period (Part 1 only), Plasma HBV DNA < LLOQ (TND) at various time points during the 48-week dosing period (Part 2 only), Change from baseline in plasma HBV DNA at various time points during the 48-week dosing period, Time to plasma HBV DNA < LLOQ (TD or TND) (Part 1 only), Time to plasma HBV DNA < LLOQ (TND) (Part 2 only), Serum HBV RNA < LLOQ at various time points during the 48-week dosing period, Change from baseline in serum HBV RNA at various time points during the 48-week dosing period, Time to serum HBV RNA < LLOQ, Subjects with abnormal ALT at baseline who have normal ALT at Week 48, Emergence of treatment-associated mutations in the HBV genome during the 48-week dosing period and the 48- to 96-week dosing period, PK parameters of ALG-001075 in plasma, including, but not limited to: Ctrough (predose), Tmax, Cmax, AUCss, and half-life, as applicable.

Source: https://euclinicaltrials.eu/ctis-public/view/2025-521178-33-00